EU clinical trial 2024-517567-23-00: Effect of Dupilumab an mucus plugs and inflammatory patterns in sEvere asThmAtiC paTients — a Pilot Study (DETACT)
Protocol code: DETACT
Sponsor: Medical University Of Vienna (Educational Institution). Phase: Phase III and phase IV (Integrated). Countries: Austria (ongoing, recruitment ended).
Therapeutic area(s): Diseases [C] - Respiratory Tract Diseases [C08]
Gender: Female, Male. Age: 18-64 years. Enrolment: 10.
Status: Ongoing, recruitment ended. Start date (EU): 2023-02-02. Decision date: 2024-12-10. Results received: No. Last updated: 2024-12-10.

Condition(s): severe asthma
Product: Dupixent 300 mg solution for injection in pre-filled syringe

Primary endpoint: To evaluate the effect of Dupilumab on mucus plugging in the airways of patients suffering from severe asthma

Source: https://euclinicaltrials.eu/ctis-public/view/2024-517567-23-00